EU clinical trial 2024-513934-40-00: Clinical utility of a next generation sequencing-based “oncochip” for therapeutic decision in metastatic breast cancer. Study SHARP
Sponsor: Istituto Europeo Di Oncologia S.r.l. (Hospital/Clinic/Other health care facility). Phase: Therapeutic exploratory (Phase II). Countries: Italy (ongoing, recruiting).
Therapeutic area(s): Diseases [C] - Neoplasms [C04]
Gender: Female. Age: 18-64 years, 65+ years. Enrolment: 400.
Status: Ongoing, recruiting. Start date (EU): 2019-09-20. Decision date: 2024-11-18. Results received: No. Last updated: 2024-11-18.

Condition(s): Metastatic breast cancer
Product: SELUMETINIB, CASODEX 50 mg compresse rivestite con film, OLAPARIB

Primary endpoint: progression free-survival
Endpoint(s): Overall survival

Source: https://euclinicaltrials.eu/ctis-public/view/2024-513934-40-00